EU clinical trial 2025-521375-31-00: Reversal of pipecuronium-induced neuromuscular blockade with Sugammadex during sevoflurane anesthesia: a drug safety randomised controlled trial
Protocol code: AITT 2025/2
Sponsor: University Of Debrecen (Educational Institution). Phase: Therapeutic use (Phase IV). Countries: Hungary (authorised, recruiting).
Therapeutic area(s): Not possible to specify
Gender: Female, Male. Age: 18-64 years. Enrolment: 80.
Status: Authorised, recruiting. Start date (EU): 2025-06-17. Decision date: 2025-06-16. Results received: No. Last updated: 2025-06-16.

Condition(s): Anesthesia and Analgesia, Patient safety

Source: https://euclinicaltrials.eu/ctis-public/view/2025-521375-31-00